EU clinical trial 2024-514693-47-01: Increasing the dosing interval of osimertinib in patients with EGFR mutated locally advanced or meta-static non-small cell lung cancer - OSI-SAVE
Sponsor: Erasmus Universitair Medisch Centrum Rotterdam (Erasmus MC) (Hospital/Clinic/Other health care facility). Phase: Phase III and phase IV (Integrated). Countries: Netherlands (ongoing, recruiting), Belgium (ongoing, recruiting).
Therapeutic area(s): Diseases [C] - Neoplasms [C04]
Gender: Female, Male. Age: 18-64 years, 65+ years. Enrolment: 283.
Status: Ongoing, recruiting. Start date (EU): 2025-10-28. Decision date: 2025-10-28. Results received: No. Last updated: 2026-03-27.
Decision dates by country: NL: 2025-10-28, BE: 2026-02-20

Condition(s): EGFR mutated locally advanced or metastatic non-small cell lung cancer
Product: TAGRISSO 80 mg film-coated tablets

Primary endpoint: Progression-free survival (PFS)
Endpoint(s): Overall survival (OS), Patient reported toxicity of any grade (laboratory abnormalities excluded), Economic assessment, Quality of life, Cumulative incidence of central nervous system (CNS) metastases, Feasibility / medication adherence

Source: https://euclinicaltrials.eu/ctis-public/view/2024-514693-47-01